EU clinical trial 2024-517149-15-00: Systemic Neoadjuvant and adjuvant Control by Precision medicine in rectal cancer (SYNCOPE) – approach on high-risk group to reduce metastases
Sponsor: HUS-Yhtymae (Hospital/Clinic/Other health care facility). Phase: Therapeutic use (Phase IV). Countries: Finland (authorised, recruitment pending).
Therapeutic area(s): Diseases [C] - Neoplasms [C04]
Gender: Female, Male. Age: 18-64 years, 65+ years. Enrolment: 100.
Status: Authorised, recruitment pending. Decision date: 2024-09-24. Results received: No. Last updated: 2024-09-24.

Condition(s): Rectal cancer
Product: Capecitabine Orion 150 mg kalvopäällysteiset tabletit, Oxaliplatin Accord 5 mg/ml, infuusiokonsentraatti, liuosta varten.

Primary endpoint: Recurrence-free survival at 3 (and 5) years at intention-to-treat analysis

Source: https://euclinicaltrials.eu/ctis-public/view/2024-517149-15-00